EU clinical trial 2024-513624-42-00: A Phase 3, Randomized, Placebo-controlled, Double-blind Study of Vimseltinib to Assess the Efficacy and Safety in Patients with Tenosynovial Giant Cell Tumor (MOTION)
Protocol code: DCC-3014-03-001
Sponsor: Deciphera Pharmaceuticals Inc. (Pharmaceutical company). Phase: Therapeutic confirmatory (Phase III). Countries: Germany (ongoing, recruitment ended), Netherlands (ongoing, recruitment ended), France (ongoing, recruitment ended), Spain (ongoing, recruitment ended), Italy (ongoing, recruitment ended), Norway (ongoing, recruitment ended), Poland (ongoing, recruitment ended).
Therapeutic area(s): Diseases [C] - Neoplasms [C04]
Gender: Female, Male. Age: 18-64 years, 65+ years. Enrolment: 79.
Status: Ongoing, recruitment ended. Start date (EU): 2021-12-16. Decision date: 2024-06-28. Results received: No. Last updated: 2026-08-03.
Decision dates by country: IT: 2024-07-29, ES: 2024-07-16, FR: 2024-07-01, DE: 2024-07-03, NO: 2024-07-02, NL: 2024-06-28, PL: 2024-07-05

Condition(s): Tenosynovial Giant Cell Tumor
Product: Placebo to match DCC-3014, DCC-3014, DCC-3014

Primary endpoint: Objective response rate (ORR, including complete response [CR] and partial response [PR]) per RECIST v1.1 at Week 25
Endpoint(s): ORR per TVS at Week 25, Change from baseline in active ROM of the affected joint, relative to a reference standard, at Week 25, Change from baseline in the Patient-reported Outcomes Measurement Information System (PROMIS) physical function score at Week 25, Change from baseline in the Worst Stiffness numeric rating scale (NRS) score at Week 25, Change from baseline in EQ-VAS (EuroQol Visual Analogue Scale) at Week 25, Response of at least a 30% improvement in the mean Brief Pain Inventory (BPI) Worst Pain NRS score without a 30% or greater increase in narcotic analgesic use at Week 25, ORR per RECIST v1.1, ORR assessed by mRECIST at Week 25, Duration of response (DOR; time from first PR or CR to disease progression or death) assessed using RECIST v1.1, TVS, and mRECIST, Incidence of treatment-emergent adverse events (TEAEs), treatmentemergent serious adverse events, related TEAEs, dose reductions, dose interruptions, and discontinuation of study drug due to adverse event, Changes from baseline in laboratory parameters, electrocardiograms (ECGs), and vital signs

Source: https://euclinicaltrials.eu/ctis-public/view/2024-513624-42-00